EU clinical trial 2024-518871-74-00: A Phase 2 Study to Evaluate the Safety and Efficacy of Telisotuzumab Adizutecan for the Treatment of Subjects with Locally Advanced or Metastatic Solid Tumors that Harbor MET Amplification
Protocol code: M25-279
Sponsor: AbbVie Deutschland GmbH & Co. KG (Pharmaceutical company). Phase: Therapeutic exploratory (Phase II). Countries: Spain (ongoing, recruiting), France (authorised, recruitment pending), Denmark (authorised, recruitment pending).
Therapeutic area(s): Diseases [C] - Neoplasms [C04]
Gender: Female, Male. Age: 0-17 years, 18-64 years, 65+ years. Enrolment: 29.
Start date (EU): 2026-06-08. Decision date: 2026-05-18. Results received: No. Last updated: 2026-06-10.
Decision dates by country: FR: 2026-05-26, ES: 2026-05-22, DK: 2026-06-10

Condition(s): Locally Advanced or Metastatic Solid Tumours that harbour MET Amplification gene
Product: Telisotuzumab adizutecan

Primary endpoint: Confirmed Objective Response (OR) as Assessed by Independent Central Review (ICR)
Endpoint(s): Duration of Response (DoR) as Assessed by ICR in participants with MET amplified positivity determined by F1CDx testing, Progression-Free Survival (PFS) as Assessed by ICR in participants with MET amplified positivity determined by F1CDx testing, Disease Control (DC) as Assessed by ICR based on RECIST v1.1 or RANO criteria as appropriate to tumor type in subjects with MET amplified positivity determined by F1CDx testing, OS in Participants with MET Amplified Positivity Determined by F1CDx Testing

Source: https://euclinicaltrials.eu/ctis-public/view/2024-518871-74-00